EU clinical trial 2024-510984-52-00: A phase 1 study of oral Debio 0123 in combination with carboplatin in patients with advanced solid tumors
Protocol code: Debio0123-101
Sponsor: Debiopharm International SA (Pharmaceutical company). Phase: Human Pharmacology (Phase I)- First administration to humans. Countries: Netherlands (ended), Spain (ended).
Therapeutic area(s): Diseases [C] - Neoplasms [C04]
Gender: Female, Male. Age: 18-64 years, 65+ years. Enrolment: 115.
Status: Ended. Start date (EU): 2019-05-24. End date (EU): 2025-10-23. End date: 2025-10-24. Decision date: 2024-05-23. Results received: No. Last updated: 2025-09-26.
Decision dates by country: NL: 2024-05-23, ES: 2024-05-23

Condition(s): Patients with tumors

Source: https://euclinicaltrials.eu/ctis-public/view/2024-510984-52-00